EU clinical trial 2024-512160-58-00: TOXSIALO-TRIAL : Evaluation of the long-term efficacy of the injection of botulinum toxin A into the salivary glands versus scopolamine patches in the treatment of drooling in children over 4 years old with cerebral palsy.
Protocol code: 69HCL18_0235
Sponsor: Hospices Civils De Lyon (Hospital/Clinic/Other health care facility). Phase: Therapeutic use (Phase IV). Countries: France (ended).
Therapeutic area(s): Diseases [C] - Nervous System Diseases [C10]
Gender: Female, Male. Age: 0-17 years. Enrolment: 132.
Status: Ended. Start date (EU): 2025-02-12. End date (EU): 2025-10-07. Decision date: 2024-07-26. Results received: No. Last updated: 2025-02-12.

Condition(s): Cerebral palsy with pathological drooling
Product: SCOPODERM TTS 1 mg/72 heures, dispositif transdermique, BOTOX 100 UNITÉS ALLERGAN, poudre pour solution injectable

Primary endpoint: Change in score of the degree and impact of the drooling between baseline and after 15 months of treatment, measured by the DIS scale
Endpoint(s): Scores of the degree and impact of the drooling, measured by the DIS scale at 1, 3, 6, 9 and 12 months of treatment (compared to the baseline measurement at the initiation of treatment at M0)., Severity of the drooling (quantity of saliva), measured by the average number of bibs used per day per patient (counted over 7 days) at 1, 3, 6, 9, 12 and 15 months (compared to the baseline measurement at treatment initiation at M0)., Clinical complications of the drooling, measured by the number of hospitalizations for pulmonary infections and the number of prescriptions for antibiotic treatment linked to bronchial secondary infection at 1, 3, 6, 9, 12 and 15 months., Description of the nature of the adverse events that have occurred (by symptom), as well as their frequency and their intensity, measured using the AE intensity scale (see § 8.1.5 safety) at each time point., Quantification of the adverse events, measured by the proportion of patients with at least one adverse event and the number of adverse events per patient at each time point., Level of treatment discontinuation due to adverse events, measured by the proportion of patients with at least one adverse event having led to a discontinuation of the treatment at each time point., Description of the nature and the frequency of the rehabilitation procedures used over 15 months., Description of the experimented strategies used (dose modifications /reinjections and their justifications) at each time point., Description of concomitant treatments used at each time point.

Source: https://euclinicaltrials.eu/ctis-public/view/2024-512160-58-00